EU clinical trial 2022-502763-37-02: Orismilast for the treatment of moderate to severe ulcerative colitis
Sponsor: Hvidovre Hospital (Hospital/Clinic/Other health care facility). Phase: Therapeutic exploratory (Phase II). Countries: Denmark (ended).
Therapeutic area(s): Diseases [C] - Immune System Diseases [C20]
Gender: Female, Male. Age: 18-64 years, 65+ years. Enrolment: 20.
Status: Ended. Start date (EU): 2023-11-16. End date (EU): 2025-02-11. Decision date: 2023-06-30. Results received: Yes. Last updated: 2023-12-14.

Condition(s): ulcerative colitis
Product: Orismilast, Orismilast

Primary endpoint: Proportion of patients with clinical remission on Total Mayo score at Week 12, defined as 2 points or lower, with no individual sub-score exceeding 1 point
Endpoint(s): Percent change in levels of high-sensitivity c reactive protein from baseline at Week 2, 4, 6 and Week 12, Percent change in levels of fecal calprotectin from baseline at Week 2, 4, 6 and Week 12, Proportion of patients with endoscopic improvement at Week 12, defined by Mayo endoscopic subscore of 0 or 1, without friability, Change from baseline in two specific items from the total Mayo score (stool frequency and rectal bleeding) known as PRO2 at Week 12, Clinical response at Week 12, defined as decrease from baseline in Total Mayo score by ≥3 points and at least 30%, with decrease in rectal bleeding subscore of ≥1, Short Inflammatory Bowel Disease Questionnaire (sIBDQ) change from baseline at Week 2, 4, 6 and Week 12, HADS (Hospital Anxiety and Depression Scale) change from baseline at Week 12, Occurrence of treatment-emergent adverse events (TEAEs), serious adverse events (SAEs), and adverse events of special interest (AESIs) at any time during the study

Source: https://euclinicaltrials.eu/ctis-public/view/2022-502763-37-02